EU clinical trial 2025-521284-12-00: Beamion LUNG-3: A randomized, controlled, multi-center trial evaluating zongertinib as an adjuvant monotherapy compared with standard of care in patients with early-stage, resectable non-small cell lung cancer (Stage II-IIIB) harboring tyrosine kinase domain activating HER2 mutations
Protocol code: 1479-0032
Sponsor: Boehringer Ingelheim International GmbH, Boehringer Ingelheim Espana S.A. (Pharmaceutical company). Phase: Therapeutic confirmatory (Phase III). Countries: Austria (authorised, recruiting), Portugal (authorised, recruiting), Netherlands (authorised, recruiting), Greece (authorised, recruitment pending), Belgium (ongoing, recruiting), Spain (authorised, recruiting), Germany (ongoing, recruiting), France (authorised, recruiting), Romania (authorised, recruiting), Sweden (authorised, recruiting), Italy (authorised, recruiting), Denmark (authorised, recruitment pending).
Therapeutic area(s): Diseases [C] - Neoplasms [C04]
Gender: Female, Male. Age: 18-64 years, 65+ years. Enrolment: 93.
Start date (EU): 2026-03-05. Decision date: 2026-01-19. Results received: No. Last updated: 2026-04-14.
Decision dates by country: BE: 2026-01-19, DK: 2026-01-20, DE: 2026-01-21, GR: 2026-01-19, IT: 2026-01-19, PT: 2026-01-21, RO: 2026-01-26, NL: 2026-01-20, AT: 2026-01-25, FR: 2026-01-26, ES: 2026-01-21, SE: 2026-01-19

Condition(s): Non-small cell lung cancer
Product: OPDIVO 10 mg/mL concentrate for solution for infusion., IMFINZI 50 mg/mL concentrate for solution for infusion., KEYTRUDA 25 mg/mL concentrate for solution for infusion, BI 1810631, Tecentriq 1 200 mg concentrate for solution for infusion

Primary endpoint: DFS by investigator's assessment. DFS is defined as the time from randomization until recurrence of tumor or death from any cause, whichever occurs earlier
Endpoint(s): OS, defined as the time from randomization until death from any cause, Occurrence of trial-related AEs ≥ Grade 3, graded according to CTCAE version 5.0, from first treatment administration (or from randomization for patients in the observation arm) until the earliest of tumor recurrence or 3 years since treatment start

Source: https://euclinicaltrials.eu/ctis-public/view/2025-521284-12-00